EU clinical trial 2022-501408-81-01: OPtimisation of antiviral Therapy in Immunocompromised COVID-19 patients: a randomized factorial controlled strategy trial: the OPTICOV Study
Protocol code: ANRS0176s OPTICOV
Sponsor: Inserm (Laboratory/Research/Testing facility). Phase: Therapeutic exploratory (Phase II). Countries: France (ongoing, recruiting), Italy (authorised, recruitment pending), Norway (authorised, recruitment pending).
Therapeutic area(s): Diseases [C] - Virus Diseases [C02]
Gender: Female, Male. Age: 0-17 years, 18-64 years, 65+ years. Enrolment: 304.
Start date (EU): 2024-03-04. Decision date: 2022-11-18. Results received: No. Last updated: 2026-02-27.
Decision dates by country: FR: 2022-11-18, IT: 2025-07-24, NO: 2025-07-28

Condition(s): Covid-19
Product: Veklury 100 mg powder for concentrate for solution for infusion, Paxlovid 150 mg + 100 mg film-coated tablets

Primary endpoint: Percentage of patients with SARS-CoV-2 viral load <32 CT by real-time RT-PCR in nasopharyngeal swabs at D10 after treatment initiation
Endpoint(s): Percentage of patients with SARS-CoV-2 viral load <32 CT by real-time RT-PCR in nasopharyngeal swabs at D5, D14 and D21 after treatment initiation, Percentage of patients with detectable SARS-CoV-2 viremia at D5, D10 and D14, Decrease of SARS-CoV-2 viral load measured by copies/ml by nasopharyngeal swab at D5, D10, D14, D21 and at D5, D10 and D14 in blood samples comparatively to screening, Number of de novo emergence of mutations on nasopharyngeal RT-PCR at D5, D10, D14 and D21 comparatively to screening, Time to first negative SARS-CoV-2 RT-PCR (CT<32) until D90, Absence of ability to cultivate virus from viral cultures from nasopharyngeal swabs at D5, D10, D14 and D21, Percentage of patients with sustained resolution or abatement or absence of signs or symptoms defined as a FLU-PRO Plus score ≤1 at D5, D10, D14, D21 and D28, All-cause hospitalisation and/or death at D28, Hospitalization at D28, Death at D28, Maximum WHO 11-point Clinical Progression Scale through D28, Any worsening of WHO 11-point Clinical Progression Scale through D28, FLU-PRO-Plus scale at D5, D10, D14, D21, D28 and D90, Rate of post-COVID-19 condition at D90 according to the WHO October 2021 definition, Percentage of participants with an adverse event (AE) or serious adverse event (SAE) or AE leading to treatment discontinuation up to D90, Adherence to nirmatrelvir/r with patient-reported adherence (PRA) and nirmatrelvir/r residual dosage at D5 and D10 from plasma sample, Number of drug-drug interactions (DDIs) which led to dosage adjustment of other patient’s drugs, Percentage of patients with specific retreatment (by antiviral, anti-inflammatory drug or convalescent plasma) through D90

Source: https://euclinicaltrials.eu/ctis-public/view/2022-501408-81-01